EU clinical trial 2025-522694-11-00: Inhaled corticosteroids in young children with episodic wheezing: a multicenter cluster RCT
Protocol code: PaNaMa 12782
Sponsor: Erasmus Universitair Medisch Centrum Rotterdam (Erasmus MC) (Hospital/Clinic/Other health care facility). Phase: Therapeutic use (Phase IV). Countries: Netherlands (ongoing, recruiting).
Therapeutic area(s): Diseases [C] - Respiratory Tract Diseases [C08]
Gender: Female, Male. Age: 0-17 years. Enrolment: 285.
Status: Ongoing, recruiting. Start date (EU): 2025-12-12. Decision date: 2025-10-09. Results received: No. Last updated: 2026-06-04.

Condition(s): Episodic expiratory wheezing
Product: SALBUTAMOL, BECLOMETASONE, BUDESONIDE, FLUTICASONE

Primary endpoint: Symptom control

Source: https://euclinicaltrials.eu/ctis-public/view/2025-522694-11-00